EU clinical trial 2024-513716-95-00: An open-label, phase I multicenter, clinical trial of NECVAX-NEO1 in addition to anti-PD-1 or anti-PD-L1 monoclonal antibody checkpoint inhibitor monotherapy in patients with solid tumors
Protocol code: NECVAX-NEO1-LT
Sponsor: Nec Oncoimmunity AS (Non-Pharmaceutical company). Phase: Human Pharmacology (Phase I)- First administration to humans. Countries: Lithuania (ended).
Therapeutic area(s): Diseases [C] - Neoplasms [C04]
Gender: Female, Male. Age: 18-64 years, 65+ years. Enrolment: 6.
Status: Ended. Start date (EU): 2022-05-16. End date (EU): 2025-08-18. Decision date: 2024-07-03. Results received: No. Last updated: 2025-07-23.

Condition(s): Non-Small Cell Lung Cancer, cutaneous melanoma, urothelial cancer, renal cell cancer, Squamous Cell Carcinoma of the Head and Neck

Source: https://euclinicaltrials.eu/ctis-public/view/2024-513716-95-00